EU clinical trial 2024-514584-25-00: A Phase 2 diagnostic study with 68Ga-EVG321 in Patients with Small Cell Lung Cancer
Protocol code: EVG001AD201
Sponsor: Evergreen Theragnostics Inc. (Pharmaceutical company). Phase: Therapeutic exploratory (Phase II). Countries: Austria (ongoing, recruiting), Italy (ongoing, recruiting), Germany (authorised, recruitment pending).
Therapeutic area(s): Analytical, Diagnostic and Therapeutic Techniques and Equipment [E] - Diagnosis [E01]
Gender: Female, Male. Age: 18-64 years, 65+ years. Enrolment: 23.
Start date (EU): 2024-12-16. Decision date: 2024-10-10. Results received: No. Last updated: 2026-08-05.
Decision dates by country: AT: 2024-10-14, IT: 2024-10-21, DE: 2024-10-10

Condition(s): Small Cell Lung Cancer

Primary endpoint: Quantitative measurements of 68Ga-EVG321 radioactivity in volumes of interest (VOIs) from whole-body images over target organs will be made at several time points post injection (p.i.): (15±10 min, 60±20 min, 120±30 min, 180±60 min).
Endpoint(s): Safety and tolerability, including treatment emergent adverse events and pre/post-68Ga-EVG321 PET/CT lab values, ECGs and vital signs, Pharmacokinetic parameters [e.g., Cmax, area under the curve (AUC), total clearance (CL), steady-state volume of distribution (Vss) and mean residence time (MRT)] of 68Ga- EVG321 in both healthy tissues and primary/metastatic lesions, Comparison of 68Ga-EVG321 PET/CT imaging to determine the presence of CCK2R expressing SCLC relative to histopathology

Source: https://euclinicaltrials.eu/ctis-public/view/2024-514584-25-00